EU clinical trial 2024-516277-68-00: FREE-study; De-escalation of anti-TNF therapy in adolescents and young adults with IBD with tight faecal calprotectin and trough level monitoring
Sponsor: Universitair Medisch Centrum Groningen (Hospital/Clinic/Other health care facility). Phase: Therapeutic use (Phase IV). Countries: Belgium (ongoing, recruiting), Netherlands (ongoing, recruiting), Spain (ongoing, recruiting).
Therapeutic area(s): Diseases [C] - Digestive System Diseases [C06]
Gender: Female, Male. Age: 0-17 years, 18-64 years. Enrolment: 148.
Status: Ongoing, recruiting. Start date (EU): 2024-09-19. Decision date: 2024-09-19. Results received: No. Last updated: 2024-09-23.
Decision dates by country: BE: 2024-09-20, ES: 2024-09-23, NL: 2024-09-19

Condition(s): Crohn's disease Ulcerative colitis
Product: ADALIMUMAB, INFLIXIMAB

Primary endpoint: The cumulative incidence of out-of-range FC results at 48 weeks follow-up
Endpoint(s): time to get out-of-range FC results, defined as the time from study baseline until the first out-of-range FC result, cumulative incidence of anti-TNF-associated respiratory infections and dermatological adverse effects (skin infections, new-onset or worsening of psoriasis, eczema, erythema nodosum, pyoderma gangrenosum, seborrheic dermatitis and other skin, hair or nail abnormalities) at 48 weeks follow-up, evolution of FC and anti-TNF trough levels in the first 16 weeks after reverting to previous dosing interval, proportion of patients developing loss-of-response in the first 16 weeks after reverting to the previous dosing interval, identification of predictors of successful de-escalation

Source: https://euclinicaltrials.eu/ctis-public/view/2024-516277-68-00